EU clinical trial 2024-517508-12-00: Infections after hysterectomy - a placebo controlled study comparing the profylactic use of azithromycin and cefuroxime with single cefuroxime
Sponsor: HUS-Yhtymae (Hospital/Clinic/Other health care facility). Phase: Therapeutic use (Phase IV). Countries: Finland (ongoing, recruiting).
Therapeutic area(s): Diseases [C] - Female Urogenital Diseases and Pregnancy Complications [C13]
Gender: Female. Age: 18-64 years, 65+ years. Enrolment: 2278.
Status: Ongoing, recruiting. Start date (EU): 2024-10-24. Decision date: 2024-10-24. Results received: No. Last updated: 2026-01-20.

Condition(s): Undergoing hysterectomy
Product: AZITHROMYCIN, Placebo 9mm tablet, product number 9905609 (Consists of Cellulos.microcrist. (Emcocel 90M); Magn.stear.). Manufactured by HUS Apteekki.

Primary endpoint: Deep wound and pelvic organ infections up to 30 days postoperatively
Endpoint(s): Surficial infections and other infections, such has urine tract infections, and fever over 38 ℃ over 2 days.

Source: https://euclinicaltrials.eu/ctis-public/view/2024-517508-12-00